EU clinical trial 2024-516958-22-00: A placebo controlled, randomized, double-blind, dose titration phase 2, safety and efficacy study of ORE-001 (oral lidocaine) in underweight elderly participants
Protocol code: OREPhIIElderly
Sponsor: Orexa B.V. (Pharmaceutical company). Phase: Therapeutic exploratory (Phase II). Countries: Netherlands (authorised, recruiting).
Therapeutic area(s): Diseases [C] - Nutritional and Metabolic Diseases [C18]
Gender: Female, Male. Age: 65+ years. Enrolment: 60.
Status: Authorised, recruiting. Start date (EU): 2025-02-17. Decision date: 2025-02-12. Results received: No. Last updated: 2025-02-12.

Condition(s): Underweight
Product: The placebo tablets are white to off-white, round, film-coated tablets with a diameter of approximately 10 mm. The placebo tablets are packaged in pvc/alu blisters.

Primary endpoint: Change from baseline in the weight of food intake of a standardized lunch on treatment day 1., Change from baseline in the weight of food intake of a standardized lunch on treatment day 42.
Endpoint(s): Change from baseline in the weight of food intake of a standardized lunch over time (i.e., on treatment days 7 and 14)., Change from baseline in VAS scores for appetite sensations in the difference before and after consumption of a standardized lunch over time (i.e., on treatment days 1, 7, 14, and 42), Change from baseline in VAS scores for GI symptoms in the difference before and after consumption of a standardized lunch over time (i.e., on treatment days 1, 7, 14 and 42)., Change from baseline in body weight over time (i.e., on treatment days 1, 7, 14, and 42), SF-6D score over time (at baseline and on treatment day 42)., PGI-S score over time (at baseline and on treatment day 42)., PGI-I score on treatment day 42., Occurrence of Treatment-Emergent AEs up to end of study., Occurrence of Treatment-Emergent SAEs up to end of study.

Source: https://euclinicaltrials.eu/ctis-public/view/2024-516958-22-00